EU clinical trial 2023-504718-31-00: A Phase 2b/3, Randomized, Double-blind, Placebo-controlled, Parallel-group, Multicenter Protocol to Evaluate the Efficacy and Safety of Guselkumab in Participants with Moderately to Severely Active Ulcerative Colitis
Protocol code: CNTO1959UCO3001
Sponsor: Janssen - Cilag International (Pharmaceutical company). Phase: Phase II and Phase III (Integrated). Countries: Bulgaria (ongoing, recruitment ended), Latvia (ongoing, recruitment ended), Slovakia (ongoing, recruitment ended), Belgium (ongoing, recruitment ended), Spain (ongoing, recruitment ended), Italy (ongoing, recruitment ended), Poland (ongoing, recruitment ended), Czechia (ongoing, recruitment ended), France (ongoing, recruitment ended), Hungary (ongoing, recruitment ended), Germany (ongoing, recruitment ended), Portugal (ended), Sweden (ongoing, recruitment ended).
Therapeutic area(s): Diseases [C] - Digestive System Diseases [C06]
Gender: Female, Male. Age: 18-64 years, 65+ years. Enrolment: 460.
Start date (EU): 2019-10-19. Decision date: 2024-07-10. Results received: No. Last updated: 2026-07-06.
Decision dates by country: PT: 2024-07-10, BE: 2024-07-11, BG: 2024-07-12, CZ: 2024-07-11, FR: 2024-07-11, DE: 2024-07-10, IT: 2024-07-15, LV: 2024-07-10, PL: 2024-07-29, SK: 2024-07-10, ES: 2024-07-11, SE: 2024-07-10, HU: 2024-07-15

Condition(s): Moderately to Severely Active Ulcerative Colitis
Product: Guselkumab 1 mL PFS Placebo, Guselkumab - solution for injection in pre-filled syringe - 100 mg/mL

Primary endpoint: Clinical Response at Induction Week 12

Source: https://euclinicaltrials.eu/ctis-public/view/2023-504718-31-00